EU clinical trial 2024-518730-88-00: Enhancing Lung Health in Kids with structural Lung Damage and Malformations: a randomized controlled trial on Azithromycin (AZI) for Airway Infection Prevention
Sponsor: Rigshospitalet (Hospital/Clinic/Other health care facility). Phase: Therapeutic use (Phase IV). Countries: Denmark (authorised, recruiting).
Therapeutic area(s): Diseases [C] - Bacterial Infections and Mycoses [C01]; Diseases [C] - Respiratory Tract Diseases [C08]
Gender: Female, Male. Age: 0-17 years. Enrolment: 150.
Status: Authorised, recruiting. Start date (EU): 2026-07-10. Decision date: 2025-11-14. Results received: No. Last updated: 2026-03-20.

Condition(s): Chronic Atelectasis, Cystic Lung Malformations, Bronchiectasis, BronchoPulmonary Dysplasia, Tracheomalacia, Lobar Hyperinflation Syndrome, Post-Vascular Ring with central airway compression
Product: ZITHROMAX 40 mg/ml pulver till oral suspension, Placebo for Azithromycin

Primary endpoint: Difference in the number of respiratory exacerbations between the treatment groups in the intervention period in the intervention period
Endpoint(s): Difference in duration of exacerbations between the treatment groups in the intervention period, Difference in number of hospital admissions between the treatment groups in the intervention period, Difference in duration of hospital admissions between the treatment groups in the intervention period

Source: https://euclinicaltrials.eu/ctis-public/view/2024-518730-88-00